EU clinical trial 2023-504166-37-00: A Randomized Study of Paclitaxel – Carboplatin followed by maintenance Niraparib compared to Paclitaxel – Carboplatin – Bevacizumab followed by maintenance Niraparib + Bevacizumab in Patients With Advanced Ovarian Cancer Following a Front-Line Complete Cytoreductive Surgery (NIRVANA-1 study)
Protocol code: GINECO-OV129b
Sponsor: Arcagy Gineco (Laboratory/Research/Testing facility). Phase: Therapeutic exploratory (Phase II). Countries: Italy (ongoing, recruiting), Spain (ongoing, recruiting), France (ongoing, recruiting), Belgium (ongoing, recruiting).
Therapeutic area(s): Diseases [C] - Neoplasms [C04]
Gender: Female. Age: 18-64 years, 65+ years. Enrolment: 336.
Status: Ongoing, recruiting. Start date (EU): 2022-02-01. Decision date: 2024-06-25. Results received: No. Last updated: 2026-04-24.
Decision dates by country: IT: 2024-07-02, FR: 2024-06-25, ES: 2024-06-26, BE: 2025-03-12

Condition(s): Advanced ovarian, tubal or peritoneal cancer.
Product: MVASI 25 mg/mL concentrate for solution for infusion, Zejula 100 mg film-coated tablets, Zejula 100 mg hard capsules

Primary endpoint: Progression-Free Survival (PFS) is defined as time from randomization until objective tumor progression or death, whichever occurs first.
Endpoint(s): Progression Free Survival (PFS), Progression Free Survival 2 (PFS2), Safety (assessed based on CTCAE version 5), Time to First Subsequent Treatment (TFST), Time to Second Subsequent Treatment (TSST), Overall survival (OS) at 5 years, Confirm the predictive value (overall chemo-sensitivity) of the KELIM (CA-125 Elimination rate constant K)

Source: https://euclinicaltrials.eu/ctis-public/view/2023-504166-37-00